EU clinical trial 2023-508306-15-00: A Phase 3 Double-blind, Randomized, Placebo-controlled, Multi-center Trial to Evaluate the Efficacy and Safety of AR1001 over 52 Weeks in Participants with Early Alzheimer’s Disease.
Protocol code: AR1001-ADP3-US01
Sponsor: Aribio Co. Ltd. (Pharmaceutical company). Phase: Therapeutic confirmatory (Phase III). Countries: France (ongoing, recruitment ended), Italy (ongoing, recruitment ended), Spain (ongoing, recruitment ended), Czechia (ongoing, recruitment ended), Germany (ongoing, recruitment ended), Netherlands (ongoing, recruitment ended), Denmark (ongoing, recruitment ended), Poland (ongoing, recruitment ended).
Therapeutic area(s): Diseases [C] - Nervous System Diseases [C10]
Gender: Female, Male. Age: 18-64 years, 65+ years. Enrolment: 479.
Status: Ongoing, recruitment ended. Start date (EU): 2024-06-26. Decision date: 2024-04-22. Results received: No. Last updated: 2026-07-22.
Decision dates by country: DK: 2024-05-29, PL: 2024-09-16, NL: 2024-05-29, CZ: 2024-04-23, ES: 2024-05-29, IT: 2024-04-24, DE: 2024-05-29, FR: 2024-04-22

Condition(s): Alzheimer’s Disease
Product: AR1001, AR1001, Placebo tablet

Primary endpoint: 1. Change in the CDR-SB from Baseline to Week 52 in at least one of the following populations: monotherapy or overall
Endpoint(s): 1. Change in the Alzheimer’s Disease Assessment Scale - Cognitive Subscale 13 (ADAS-Cog 13) from Baseline to Week 52: monotherapy or overall, 2. Change in the Amsterdam-Instrumental Activities of Daily Living Questionnaire-Short Version (A-IADL-Q-SV) from Baseline to Week 52: monotherapy or overall, 3. Change in the Geriatric Depression Scale-15 (GDS-15) from Baseline to Week 52: monotherapy or overall, 4. Change in the Mini-Mental Status Examination (MMSE) from Baseline to Week 52: monotherapy or overall

Source: https://euclinicaltrials.eu/ctis-public/view/2023-508306-15-00